EU clinical trial 2024-517873-25-00: Pharmacokinetics and penetrability of clindamycin and cefalexin into bone tissue
Sponsor: Medical University Of Vienna (Educational Institution). Phase: Human Pharmacology (Phase I)- Other. Countries: Austria (ongoing, recruiting).
Therapeutic area(s): Diseases [C] - Bacterial Infections and Mycoses [C01]
Gender: Female, Male. Age: 18-64 years, 65+ years. Enrolment: 24.
Status: Ongoing, recruiting. Start date (EU): 2023-08-03. Decision date: 2024-10-14. Results received: No. Last updated: 2025-11-06.

Condition(s): Patients undergoing planned amputation surgery of any part of any extremity

Source: https://euclinicaltrials.eu/ctis-public/view/2024-517873-25-00